EU clinical trial 2023-507520-23-00: Absolute quantification of myocardial blood flow in human subjects with SYN2 dynamic PET imaging
Protocol code: SAFER2a
Sponsor: Synektik S.A. (Pharmaceutical company). Phase: Therapeutic exploratory (Phase II). Countries: Poland (ongoing, recruiting).
Therapeutic area(s): Diseases [C] - Cardiovascular Diseases [C14]
Gender: Female, Male. Age: 18-64 years, 65+ years. Enrolment: 30.
Status: Ongoing, recruiting. Start date (EU): 2024-09-03. Decision date: 2024-01-22. Results received: No. Last updated: 2026-03-23.

Condition(s): Coronary Artery Disease
Product: Adenosine 6 mg/2 ml solution for injection, SYN2, Rapiscan 400 microgram solution for injection

Primary endpoint: The agreement of flow estimates between 13N-ammonia and SYN2.
Endpoint(s): Variability of flow estimates as compared to 13N-ammonia due to patient characteristics (sex, weight, body weight index, hematocrit) and motion and sensitivity of flow measurements to model parameters., The coefficient of variation (CV)% of repeated analyses within and between two different observers in scans performed at rest and during stress are defined., Adverse events and reportable serious adverse events during the resting study as defined by the NCI Common Toxicity Criteria for Adverse Events; CTCAE v.5.0.

Source: https://euclinicaltrials.eu/ctis-public/view/2023-507520-23-00